EU clinical trial 2024-519760-40-00: Hepatic radiotherapy added to standard of care for the treatment of HLA A*02:01 positive Metastatic Uveal Melanoma patients
Protocol code: TEBE-RT
Sponsor: Fondazione Policlinico Universitario Agostino Gemelli IRCCS (Hospital/Clinic/Other health care facility). Phase: Therapeutic exploratory (Phase II). Countries: Italy (ongoing, recruiting).
Therapeutic area(s): Diseases [C] - Neoplasms [C04]
Gender: Female, Male. Age: 18-64 years, 65+ years. Enrolment: 20.
Status: Ongoing, recruiting. Start date (EU): 2025-10-14. Decision date: 2025-07-21. Results received: No. Last updated: 2025-07-21.

Condition(s): metastatic uveal melanoma HLA A*02:01 positive
Product: TEBENTAFUSP

Primary endpoint: The primary endpoint is the progression-free survival, which will be calculated from the day of treatment initiation to the progression. The PFS rate at 6 months will be evaluated
Endpoint(s): disease control rate at first tumor assessment, objective response rate, overall survival, treatment duration, time to subsequent treatment initiation, safety, evaluation of patients’ circulating immune profile and inflammatory microenvironment of uveal melanoma and correlation with PFS, analysis of ctDNA and correlation with PFS and OS

Source: https://euclinicaltrials.eu/ctis-public/view/2024-519760-40-00